EU clinical trial 2024-512079-11-00: Safety study for the use of Rapamycin in children with familial adenomatous polyposis - RAPA-4-FAP
Protocol code: RC31/23/0388
Sponsor: Centre Hospitalier Universitaire De Toulouse (Hospital/Clinic/Other health care facility). Phase: Therapeutic exploratory (Phase II). Countries: France (authorised, recruitment pending).
Therapeutic area(s): Diseases [C] - Digestive System Diseases [C06]
Gender: Female, Male. Age: 0-17 years. Enrolment: 25.
Status: Authorised, recruitment pending. Decision date: 2024-09-12. Results received: No. Last updated: 2026-07-30.

Condition(s): Familial adenomatous polyposis
Product: Rapamune 2 mg coated tablets

Primary endpoint: Monitoring of adverse events (AEs) and serious adverse events (SAEs) for the duration of the experimental drug (rapamycin) and up to one month after discontinuation.
Endpoint(s): Individual analysis of colonoscopies, blinded to patient identity and the timing of colonoscopy in relation to treatment (V1 or V12), enabling descriptive analysis of the number of polyps over 2 mm per segment (rectum, left colon, transverse colon, right colon) and the size of the largest polyp in each segment., Analysis of colonoscopies in a matched manner for each patient (pre-treatment (V1) / post-treatment (V12)) in order to be able to carry out a more specific evaluation of the evolution of polyps after 6 months of rapamycin treatment., The biological sample collection will be used and analyzed in future research projects that will examine the gut microbiota and characterize intestinal stem cells. This will enable us to assess the impact of rapamycin on these parameters. This collection is limited to patients who will be enrolled at the Toulouse University Hospital (CHU) research center.

Source: https://euclinicaltrials.eu/ctis-public/view/2024-512079-11-00